EU clinical trial 2024-515959-38-00: A Phase 2b, Randomized, Double-Blind, Placebo-Controlled, Multicenter Study of the Efficacy and Safety of Brensocatib in Adults with Moderate to Severe Hidradenitis Suppurativa – The CEDAR Study
Protocol code: INS1007-231
Sponsor: Insmed Inc. (Pharmaceutical company). Phase: Therapeutic exploratory (Phase II). Countries: Germany (ended), France (ended), Spain (ended), Bulgaria (ended), Netherlands (ended), Poland (ended), Greece (ended).
Therapeutic area(s): Diseases [C] - Skin and Connective Tissue Diseases [C17]
Gender: Female, Male. Age: 18-64 years, 65+ years. Enrolment: 116.
Status: Ended. Start date (EU): 2025-03-06. End date (EU): 2026-04-08. End date: 2026-06-08. Decision date: 2025-02-24. Results received: No. Last updated: 2026-04-22.
Decision dates by country: PL: 2025-03-02, GR: 2025-02-25, DE: 2025-02-25, FR: 2025-02-24, ES: 2025-02-25, NL: 2025-03-03, BG: 2025-02-27

Condition(s): Hidradenitis Suppurativa
Product: The placebo used the same excipients as that used in IMP without active drug substance. The placebo was developed as film-coated tablet same in size and appearance to the IMP., BRENSOCATIB, BRENSOCATIB

Primary endpoint: Percent change from Baseline in total abscess and inflammatory nodule count (AN count) at Week 16
Endpoint(s): • Responder status for achieving HiSCR50 and HiSCR75 at Week 16 • Continuous secondary efficacy endpoints will be analyzed in the same fashion as the primary endpoint. For the detailed information on the secondary endpoint, please check the Protocol v1.0,12Jul2024, section 9.6, Secondary Endpoint Analyses

Source: https://euclinicaltrials.eu/ctis-public/view/2024-515959-38-00